EU clinical trial 2024-517099-39-00: ISASOCUT-IFM2022-05-Multicenter phase 2 study of subcutaneous isatuximab plus bortezomib, lenalidomide and dexamethasone in the treatment of newly diagnosed transplant ineligible multiple myeloma
Protocol code: ISASOCUT-IFM2022-05
Sponsor: Centre Hospitalier Universitaire De Poitiers (Hospital/Clinic/Other health care facility). Phase: Therapeutic exploratory (Phase II). Countries: France (ongoing, recruitment ended).
Therapeutic area(s): Diseases [C] - Hemic and Lymphatic Diseases [C15]
Gender: Female, Male. Age: 65+ years. Enrolment: 74.
Status: Ongoing, recruitment ended. Start date (EU): 2024-11-18. Decision date: 2024-11-18. Results received: No. Last updated: 2026-02-18.

Condition(s): Newly diagnosed transplant ineligible multiple myeloma
Product: DEXAMETHASONE, SARCLISA 20mg/mL concentrate for solution for infusion., Revlimid 25 mg hard capsules, VELCADE 3.5 mg powder for solution for injection, DEXAMETHASONE

Primary endpoint: very good partial response rate (VGPR) will be assessed according to IMWG international criteria*
Endpoint(s): To determine Survivals, Overall Survival (OS), Progression free survival (PFS), Time to Progression (TTP), Time to Next Therapy (TTNT) and Event Free survival (EFS), To determine duration of response (DOR) and time to response (TTR), To assess responses to the treatment according to IMWG*, ORR (Overall response rate) >=PR, >=CR (complete response), and best MRD 10-5 rate + sustained 12 and 24 months., To assess the safety, including infusions reactions, device deficiencies, and local tolerability (injections site reactions) of SC isatuximab + VRd according to CTCAE 5.0., Patient experience/satisfaction questionnaire with SC isatuximab using the patient experience and satisfaction questionnaire, To assess of abilities and life quality of patients QLQ-C30, QLQ-MY20 and EQ-5D-5L, FOR MIBAPIX AND PK-ADA•To estimate isatuximab PK parameters and derived exposure by population PK modelling, FOR MIBAPIX AND PK-ADA• Incidence of participants with anti-drug antibodies (ADA) against isatuximab, FOR MIBAPIX AND PK-ADA• To determine apixaban plasma exposure with the area under the concentration curve in relation to time

Source: https://euclinicaltrials.eu/ctis-public/view/2024-517099-39-00